EU clinical trial 2023-510458-18-00: AIM4: Next Step – Asthma Uncontrolled With ICS in Medium Dose (GINA 4): Next Step; Efficacy of Dupilumab Added to Medium Dose ICS/LABA in Comparison to ICS Dose Escalation to High Dose ICS/LABA in Patients With Uncontrolled Asthma
Protocol code: R668-AS-2373
Sponsor: Regeneron Pharmaceuticals Inc. (Pharmaceutical company). Phase: Therapeutic use (Phase IV). Countries: Poland (ongoing, recruitment ended), Denmark (ended), Germany (ongoing, recruitment ended).
Therapeutic area(s): Diseases [C] - Respiratory Tract Diseases [C08]
Gender: Female, Male. Age: 0-17 years, 18-64 years, 65+ years. Enrolment: 62.
Start date (EU): 2025-03-11. Decision date: 2024-10-07. Results received: No. Last updated: 2025-10-21.
Decision dates by country: DK: 2024-10-07, DE: 2024-12-13, PL: 2024-12-09

Condition(s): Asthma
Product: Advair HFA 230mcg/21mcg, Dupixent 300 mg solution for injection in pre-filled syringe, Placebo matching to dupilumab, Advair HFA 115 mcg/21 mcg

Primary endpoint: Annualized severe asthma exacerbation rate
Endpoint(s): Change in pre-bronchodilator Forced Expiratory Volume in the first second (FEV1), Annualized cumulative dose of systemic corticosteroid exposure to treat severe asthma exacerbations, Change in Asthma Control Questionnaire (ACQ-5), Proportion of participants achieving ACQ-5 <1.5, Change in pre-bronchodilator FEV1, Change in percent of predicted FEV1, Change in peak expiratory flow (PEF), Change in forced vital capacity (FVC), Change in forced expiratory flow (FEF) 25-75%, Change in FEV1:FVC ratio, Change in post-bronchodilator FEV1, Time to first severe exacerbation event, Proportion of participants achieving a 0.5-point improvement minimal clinically important difference (MCID) in ACQ-5, Incidence of Treatment-emergent adverse events (TEAEs)

Source: https://euclinicaltrials.eu/ctis-public/view/2023-510458-18-00